EU clinical trial 2022-503091-89-00: A Phase 2, Multicenter, Randomized, Double-Blinded, Placebo-Controlled Study to Assess the Safety, Efficacy, and Tolerability of ARGX-117 in Improving Allograft Function in Recipients of a Deceased Donor Renal Allograft at Risk for Delayed Graft Function (Varvara)
Protocol code: ARGX-117-2201
Sponsor: Argenx (Pharmaceutical company). Phase: Therapeutic exploratory (Phase II). Countries: Belgium (ended), Spain (ongoing, recruitment ended), Portugal (ongoing, recruitment ended), Italy (ongoing, recruitment ended), France (ended), Austria (ongoing, recruitment ended), Sweden (ongoing, recruitment ended).
Therapeutic area(s): Diseases [C] - Immune System Diseases [C20]
Gender: Female, Male. Age: 18-64 years, 65+ years. Enrolment: 87.
Start date (EU): 2024-02-15. Decision date: 2023-10-03. Results received: No. Last updated: 2026-07-09.
Decision dates by country: FR: 2023-10-06, IT: 2023-10-05, BE: 2023-10-03, AT: 2023-10-09, ES: 2023-10-04, SE: 2024-05-30, PT: 2023-10-04

Condition(s): Delayed graft function
Product: ARGX-117, Placebo to ARGX-117 IV concentrate solution for infusion.

Primary endpoint: eGFR at 24 weeks posttransplant
Endpoint(s): Proportion of participants with DGF, Proportion of participants with fDGF, Duration of dialysis treatment for DGF within the first 30 days posttransplant (ie, date of last dialysis treatment), CRR at 72 hours posttransplant and on study day 8, iBox score at 52 weeks posttransplant, Dialysis-free participant survival through 52 weeks posttransplant, eGFR at 52 weeks posttransplant, Safety outcomes, including AE and AESI incidence, vital sign measurements, clinical laboratory tests, Incidence of PNF, Serum concentrations and PK parameters for ARGX-117, Values and changes from baseline in free C2, total C2, and CH50 activity, Incidence and prevalence of ADA against ARGX-117, Proportion of participants who have ongoing dialysis requirement at study day 31, (Death-censored) allograft survival through 52 weeks posttransplant

Source: https://euclinicaltrials.eu/ctis-public/view/2022-503091-89-00